EU clinical trial 2023-504989-37-00: A Randomized, Controlled, Multiregional Phase 3 Study of Ivonescimab Combined with Chemotherapy Versus Pembrolizumab Combined with Chemotherapy for the First-line Treatment of Metastatic Squamous Non-small Cell Lung Cancer
Protocol code: SMT112-3003
Sponsor: Summit Therapeutics Sub Inc. (Pharmaceutical company). Phase: Therapeutic confirmatory (Phase III). Countries: Germany (not authorised), Italy (not authorised), Spain (not authorised), France (not authorised), Ireland (not authorised), Greece (not authorised), Poland (not authorised).
Therapeutic area(s): Diseases [C] - Neoplasms [C04]
Gender: Female, Male. Age: 18-64 years, 65+ years. Enrolment: 135.
Status: Not authorised. Decision date: 2024-01-05. Results received: No. Last updated: 2024-01-08.
Decision dates by country: FR: 2024-01-05, DE: 2024-01-08, IE: 2024-01-08, IT: 2024-01-08, ES: 2024-01-08, PL: 2024-01-08, GR: 2024-01-08

Condition(s): Metastatic Squamous Non-small Cell Lung Cancer
Product: Paclitaxel Ribosepharm 6 mg/ml Konzentrat zur Herstellung einer Infusionslösung, Abraxane 5 mg/ml powder for dispersion for infusion., Carboplatin 10 mg/ml concentrate for solution for infusion, Pazenir 5 mg/ml powder for dispersion for infusion, ivonescimab, KEYTRUDA 25 mg/mL concentrate for solution for infusion

Primary endpoint: Overall Survival (OS)
Endpoint(s): PFS assessed by investigator based on RECIST v1.1, ORR (including DoR) assessed by investigator based on RECIST v1.1, Safety assessment: incidence and severity of adverse events (AEs) and clinically significant abnormal laboratory test results, PK characteristics: ivonescimab serum drug concentrations profiles, Immunogenicity: number and percentage of patients with detectable anti-ivonescimab antibody (ADA) at baseline and post treatment

Source: https://euclinicaltrials.eu/ctis-public/view/2023-504989-37-00